EU clinical trial 2024-518816-38-00: Intranasal dexmedetomidine sedation and analgesia during minor procedures in the pediatric emergency room: Randomized double-blinded clinical trial
Protocol code: OY072017
Sponsor: Oulu University Hospital (Hospital/Clinic/Other health care facility). Phase: Therapeutic use (Phase IV). Countries: Finland (ongoing, recruiting).
Therapeutic area(s): Analytical, Diagnostic and Therapeutic Techniques and Equipment [E] - Anesthesia and Analgesia [E03]
Gender: Female, Male. Age: 0-17 years. Enrolment: 112.
Status: Ongoing, recruiting. Start date (EU): 2024-11-05. Decision date: 2024-11-05. Results received: No. Last updated: 2024-11-05.

Condition(s): Patients of the pediatric emergency room at Oulu University Hospital with any medical condition requiring a minor painful procedure such as i.v. cannulation or lumbar puncture are asked to join our study if they would seem to benefit from a sedative drug during the procedure.
Product: DEXMEDETOMIDINE, SODIUM CHLORIDE

Primary endpoint: The success of the procedure at the first attempt
Endpoint(s): The duration of the procedure, Parents assessment of the patients comfortability during the procedure, Patient's and physician's assessment of the experienced pain with Visual Analog Scale, Assessment of pain levels of the patient with FLACC-scores, Assessment of sedation levels of the patient with Comfort-B-scores, Duration of crying, The parents and the emergency room nurses are asked whether they think the patient recieved the experimental drug or placebo, Blood pressure measured by manometer, Respiratory rate assessed by capnometry, Oxygen saturation is measured by pulse oxymetry, Heart rate measured by ECG

Source: https://euclinicaltrials.eu/ctis-public/view/2024-518816-38-00